EU clinical trial 2023-508925-29-00: A phase I dose finding study of oral TNO155 in adult patients with advanced solid tumors
Protocol code: CTNO155X2101
Sponsor: Novartis Pharma AG (Pharmaceutical company). Phase: Human Pharmacology (Phase I)- First administration to humans. Countries: Netherlands (ended), Italy (ended), Spain (ended).
Therapeutic area(s): Diseases [C] - Neoplasms [C04]
Gender: Female, Male. Age: 18-64 years, 65+ years. Enrolment: 113.
Status: Ended. Start date (EU): 2017-06-29. End date (EU): 2025-07-04. End date: 2025-07-05. Decision date: 2024-04-10. Results received: No. Last updated: 2025-02-27.
Decision dates by country: IT: 2024-04-12, NL: 2024-04-12, ES: 2024-04-10

Condition(s): Advanced solid tumors

Source: https://euclinicaltrials.eu/ctis-public/view/2023-508925-29-00